EU clinical trial 2022-500687-35-00: A Single-Arm, Open-Label, Multicenter Phase 1/2 Study to Evaluate the Efficacy, Safety, and Pharmacokinetics of Bcl 2 Inhibitor BGB-11417 in Patients With Relapsed or Refractory Mantle Cell Lymphoma
Protocol code: BGB-11417-201
Sponsor: BeOne Medicines AG (Pharmaceutical company). Phase: Phase I and Phase II (Integrated)- Other. Countries: Germany (ongoing, recruitment ended), Poland (ongoing, recruitment ended), France (ongoing, recruitment ended), Spain (ongoing, recruitment ended), Belgium (ended), Italy (ended).
Therapeutic area(s): Diseases [C] - Neoplasms [C04]
Gender: Female, Male. Age: 18-64 years, 65+ years. Enrolment: 31.
Start date (EU): 2023-04-04. Decision date: 2023-01-12. Results received: No. Last updated: 2026-08-06.
Decision dates by country: BE: 2023-07-07, PL: 2023-04-03, IT: 2023-07-11, FR: 2023-01-12, ES: 2023-01-16, DE: 2023-01-13

Condition(s): Refractory Mantle Cell Lymphoma
Product: BGB-11417, BGB-11417, BGB-11417, BGB-11417

Primary endpoint: Part 1: Dose limiting toxicity (DLT), Part 1 : The incidence and severity according to the NCI-CTCAE v5.0 of TEAEs, SAEs, and AEs leading to discontinuation of BGB-11417, Part 1: Incidence and severity of TLS-relevant events, Part 2: Overall response rate as determined by the Independent Review Committee (IRC) in accordance with the Lugano classification
Endpoint(s): Part 1:Area Under the Plasma Concentration Time Curve (AUC), Part 1:Maximum Observed Plasma Concentration (Cmax), Part 1: Time to reach Cmax (Tmax), Part 1: Steady State Area Under the Plasma Concentration Time Curve (AUC), Part 1: Steady State Maximum Observed Plasma Concentration (Cmax), Part 1: Steady State Trough Plasma Concentration (CTrough), Part 1: Steady State Time to reach Cmax (Tmax), Overall Response Rate (ORR) as assessed by investigator and IRC. Defined as the proportion of participants who achieved a complete response (CR), or partial response (PR) per Lugano classification, Duration of Response (DOR) as assessed by investigator and IRC. DOR is defined as the time from the date of the first documented response (PR or better) after treatment initiation until the date of first documented disease progression or death due to any cause; whichever occurs first, Progression Free Survival (PFS) as assessed by investigator and IRC. PFS is defined as the time from the date of the first study dose until the date of first documented disease progression or death due to any cause, whichever occurs first., Time to Response (TTR) as assessed by investigator and IRC. TTR is defined as the time from start of treatment to first documentation of response of Partial Response (PR) or better, Overall Survival (OS), defined as time from the start of treatment to the date of death due to any cause., Part 2: Number of Participants Experiencing Adverse Events (AEs), Part 2: Number of participants with clinically significant changes from baseline in vital signs. Vital signs include blood pressure and pulse rate, Part 2: Number of participants with clinically significant changes from baseline in clinical laboratory values. Laboratory values include hematology, clinical chemistry, coagulation, and urinalysis, Number of Participants With Clinically Significant Physical Examination Findings. A full physical examination includes head, ears, eyes, nose, mouth, skin, heart and lung examinations, lymph nodes, gastrointestinal and musculoskeletal systems, Participant Reported Outcomes as measured by NFLymSI-18 and EQ-5D-5L questionnaires

Source: https://euclinicaltrials.eu/ctis-public/view/2022-500687-35-00